EU clinical trial 2023-505592-69-00: [18F]F-FAPI PET-CT to Identify Carcinoma of Unknown Primary origin
Sponsor: Erasmus Universitair Medisch Centrum Rotterdam (Erasmus MC) (Hospital/Clinic/Other health care facility). Phase: Therapeutic confirmatory (Phase III). Countries: Netherlands (ongoing, recruitment ended).
Therapeutic area(s): Diseases [C] - Neoplasms [C04]
Gender: Female, Male. Age: 18-64 years, 65+ years. Enrolment: 50.
Status: Ongoing, recruitment ended. Start date (EU): 2024-07-12. Decision date: 2024-03-08. Results received: No. Last updated: 2026-01-21.
Decision dates by country: NL: 2024-06-18

Condition(s): Carcinoma of Unknown Primary
Product: [18F]-AlF-FAPI-74

Primary endpoint: The proportion of CUP patients in whom the primary tumor is identified by [18F]F-FAPI PET-CT (i.e., the correct detection rate).
Endpoint(s): Sensitivity, specificity, positive- and negative predictive value of [18F]F-FAPI PET-CT.

Source: https://euclinicaltrials.eu/ctis-public/view/2023-505592-69-00